EU clinical trial 2023-504364-42-00: A Phase 1/2 Study Evaluating the Safety, Tolerability, Pharmacokinetics, Pharmacodynamics, and Efficacy of AMG 193 in Combination With IDE397 in Subjects With Advanced MTAP-null Solid Tumors
Protocol code: 20220127
Sponsor: Amgen Inc. (Pharmaceutical company). Phase: Phase I and Phase II (Integrated)- Other. Countries: Spain (ended), Denmark (ended).
Therapeutic area(s): Diseases [C] - Neoplasms [C04]
Gender: Female, Male. Age: 18-64 years, 65+ years. Enrolment: 12.
Status: Ended. Start date (EU): 2024-09-12. End date (EU): 2025-04-28. End date: 2026-03-26. Decision date: 2024-07-08. Results received: No. Last updated: 2024-07-10.
Decision dates by country: DK: 2024-07-10, ES: 2024-07-08

Condition(s): In Part 1, subjects with advanced MTAP-null solid tumors and, in Part 2, subjects with advanced MTAP-null Non Small-Cell Lung Cancer
Product: AMG 193, IDE397, AMG 193, IDE397, AMG 193

Primary endpoint: Part 1: Dose-limiting toxicities, certain treatment related side effects that can occur in the first cycle of treatment. Adverse events (side effects) that occur after the start of treatment, or are related to treatment, or require significant intervention. Changes in vital signs (including blood pressure, heart rate, respiratory rate, and temperature), electrocardiograms, and clinical laboratory tests, Part 2: Whether the cancer responds to treatment, either a complete or a partial improvement of cancer lesions, as assessed per Response Evaluation Criteria in Solid Tumors Version 1.1 (RECIST v1.1). RECIST is a scale set of rules used to determine if classify how a cancer patient is responding to treatment.
Endpoint(s): Blood levels of AMG 193 and IDE397 when given in combination, including, but not limited to, maximal plasma concentration (Cmax) - that is the maximum amount of study drug present in the blood plasma, time to maximal plasma concentration (tmax) - that is the time required to achieve the maximum plasma concentration, and total drug levels over time., The proportion of treated patients who respond to treatment by looking at tumor shrinkage or growth over time as assessed by CT or MRI imaging; the duration of time a tumor responds or does not increase in size while on study treatment; progression free survival (PFS) and overall survival (OS)., Part 2: Treatment emergent adverse events, serious adverse events, and changes in vital signs, electrocardiograms (ECGs), and clinical laboratory tests, Changes in blood levels of SDMA over time.

Source: https://euclinicaltrials.eu/ctis-public/view/2023-504364-42-00